EU clinical trial 2022-500418-24-00: An Open-label, Randomized, Phase 2/3 Study of Olaparib Plus Pembrolizumab Versus Chemotherapy Plus Pembrolizumab After Induction of Clinical Benefit With First-line Chemotherapy Plus Pembrolizumab in Participants With Locally Recurrent Inoperable or Metastatic Triple Negative Breast Cancer (TNBC) (KEYLYNK 009)
Protocol code: MK-7339-009
Sponsor: Merck Sharp & Dohme LLC (Pharmaceutical company). Phase: Phase II and Phase III (Integrated). Countries: Hungary (ended), Ireland (ended), Spain (ended), France (ended), Germany (ended), Poland (ended).
Therapeutic area(s): Diseases [C] - Neoplasms [C04]
Gender: Female, Male. Age: 18-64 years, 65+ years. Enrolment: 111.
Status: Ended. Start date (EU): 2020-01-17. End date (EU): 2025-11-17. End date: 2025-11-26. Decision date: 2023-02-10. Results received: No. Last updated: 2025-09-04.
Decision dates by country: PL: 2023-03-27, HU: 2023-02-13, DE: 2023-02-24, IE: 2023-02-10, ES: 2023-03-17, FR: 2023-02-17

Condition(s): Locally Recurrent Inoperable or Metastatic Triple Negative Breast Cancer (TNBC)
Product: Olaparib, CARBOPLATIN, Olaparib, GEMCITABINE, KEYTRUDA 25 mg/mL concentrate for solution for infusion

Primary endpoint: Progression-Free Survival (PFS) According to Response Evaluation Criteria in Solid Tumors Version 1.1 (RECIST 1.1), Overall Survival (OS)
Endpoint(s): Overall Survival (OS) in Participants with Programmed Cell Death Ligand 1 (PD-L1) Positive Tumors with a Combined Positive Score (CPS) ≥10, Progression-Free Survival (PFS) According to Response Evaluation Criteria in Solid Tumors Version 1.1 (RECIST 1.1) in Participants with Programmed Cell Death Ligand 1 (PD-L1) Positive Tumors with a Combined Positive Score (CPS) ≥10, Overall Survival (OS) in Participants with Breast Cancer Susceptibility Gene Mutation (BRCAm) Tumors, Progression-Free Survival (PFS) According to Response Evaluation Criteria in Solid Tumors Version 1.1 (RECIST 1.1) in Participants with Breast Cancer Susceptibility Gene Mutation (BRCAm) Tumors, Change From Baseline in Health-Related Quality-of-Life (QoL) Using the European Organization for Research and Treatment of Cancer Quality of Life Questionnaire Core 30 (EORTC QLQ-C30) Items 29 and 30 Score, Change From Baseline in Physical Functioning Using the European Organization for Research and Treatment of Cancer Quality of Life Questionnaire Core 30 (EORTC QLQ-C30) Items 1- 5 Score, Change From Baseline in Emotional Functioning Using the European Organization for Research and Treatment of Cancer Quality of Life Questionnaire Core 30 (EORTC QLQ-C30) Items 21-24 Score, Change From Baseline in Systemic Therapy Side Effects Using the European Organization for Research and Treatment of Cancer Breast Cancer-Specific Quality-of-Life (QoL) Questionnaire (EORTC QLQ-BR23) Items 1-4,6,7, and 8 Score, Time to Deterioration in Health-Related Quality-of-Life (QoL) Using the European Organization for Research and Treatment of Cancer Quality of Life Questionnaire Core 30 (EORTC QLQ-C30) Items 29 and 30 Score, Time to Deterioration in Physical Functioning Using the European Organization for Research and Treatment of Cancer Quality of Life Questionnaire Core 30 (EORTC QLQ-C30) Items 1-5 Score, Time to Deterioration in Emotional Functioning Using the European Organization for Research and Treatment of Cancer Quality of Life Questionnaire Core 30 (EORTC QLQ-C30) Items 21-24 Score, Time to Deterioration in Systemic Therapy Side Effects Using the European Organization for Research and Treatment of Cancer Breast Cancer-Specific Quality-of-Life (QoL) Questionnaire (EORTC QLQ-BR23) Items 1-4,6,7, and 8 Score, Change From Baseline in Health Outcomes using the European Quality of Life 5-dimension, 5-level Questionnaire (EQ-5D-5L) Visual Analogue Scale (VAS) Score, Number of Participants Who Experienced At Least One Adverse Event (AE), Number of Participants Who Discontinued Study Treatment Due to an Adverse Event (AE)

Source: https://euclinicaltrials.eu/ctis-public/view/2022-500418-24-00